EU clinical trial 2024-510954-28-01: Regorafenib for recurrent meningioma. A multicenter, randomized phase II study (MIRAGE trial)
Protocol code: MIRAGE
Sponsor: Istituto Oncologico Veneto (Hospital/Clinic/Other health care facility). Phase: Therapeutic exploratory (Phase II). Countries: Italy (ongoing, recruiting).
Therapeutic area(s): Diseases [C] - Neoplasms [C04]
Gender: Female, Male. Age: 18-64 years, 65+ years. Enrolment: 104.
Status: Ongoing, recruiting. Start date (EU): 2024-09-23. Decision date: 2024-07-11. Results received: No. Last updated: 2026-03-19.

Condition(s): grade 1, 2 and 3 meningioma
Product: Stivarga 40 mg film-coated tablets

Primary endpoint: The progression free survival (PFS) will be determined as the time from the date of randomization to the date of disease progression determined using RANO criteria or to the date of death, whichever occurs first. Patients without a PFS event at the time of analysis will be censored at the date of last assessment.
Endpoint(s): The overall survival (OS) will be determined as the time from the date of randomization to the date of death from any cause. Patients alive at the time of analysis will be censored at the date of last assessment., The objective response rate (ORR) will be defined as the percentage of patients with complete response (CR) and partial response (PR) determined using modified Macdonald criteria., The disease control rate (DCR) will be defined as the percentage of patients with complete response (CR), partial response (PR) and stable disease (SD) determined using modified Macdonald criteria., Quality of life will be assessed by EORTC QLQ-C30 and the QLQBN20 questionnaires. Two HRQOL measures are selected for this study, EORTC QLQ-C30 and the QLQBN20 which have robust psychometric properties resulting from their use in several international cancer clinical trials. The EORTC QLQ-C30 is a core measure designed to be supplemented with the disease specific module. Both instruments are available in Italian and have followed rigorous forward-backward translation procedures., Toxicity during the treatment will be recorded and graded according to the NCI Common Terminology Criteria for Adverse Events (CTCAE) v.5. Grade refers to the severity of the adverse event. A grading (severity) scale is provided for each adverse event term.

Source: https://euclinicaltrials.eu/ctis-public/view/2024-510954-28-01